EU clinical trial 2023-508143-51-01: Pulmonary function and sleep related disorders during cervical admission of intrathecal baclofen in spinal cord injury; a safety study
Protocol code: NL 68837.091.21
Sponsor: Roessingh Centrum Voor Revalidatie (Hospital/Clinic/Other health care facility). Phase: Therapeutic use (Phase IV). Countries: Netherlands (ongoing, recruitment ended).
Therapeutic area(s): Diseases [C] - Nervous System Diseases [C10]
Gender: Female, Male. Age: 18-64 years, 65+ years. Enrolment: 11.
Status: Ongoing, recruitment ended. Start date (EU): 2026-03-09. Decision date: 2024-05-06. Results received: No. Last updated: 2025-06-02.

Condition(s): Spinal cord Injury
Product: Baclofen Sintetica Intrathecaal 0,5 mg/ml oplossing voor infusie

Primary endpoint: The primary endpoint of the study is treatment safety, which is defined as PcCO2 between 4,7 kPa and 6,5 kPa and an AHI < 15 without complaints of SAS in patients without SAS and an AHI < 5 in patients with treated SAS. If patients use a CPAP device, it may be adjusted to stay within the safe margin. This adjustment will be registered. The spirometry is not used for safety reasons but to determine the effect of ITB on pulmonary function
Endpoint(s): Secondary endpoints are the amount of spasticity, patients satisfaction and patients level of function and activities.

Source: https://euclinicaltrials.eu/ctis-public/view/2023-508143-51-01